EU clinical trial 2024-511532-27-00: A phase II clinical trial investigating the effect of topiramate on the reactivation of the HIV-1 reservoir in people living with HIV on antiretroviral therapy
Sponsor: Erasmus Universitair Medisch Centrum Rotterdam (Erasmus MC) (Hospital/Clinic/Other health care facility). Phase: Therapeutic exploratory (Phase II). Countries: Netherlands (ongoing, recruiting).
Therapeutic area(s): Diseases [C] - Virus Diseases [C02]
Gender: Female, Male. Age: 18-64 years, 65+ years. Enrolment: 12.
Status: Ongoing, recruiting. Start date (EU): 2024-07-07. Decision date: 2024-06-17. Results received: No. Last updated: 2025-10-13.

Condition(s): human immunodeficiency virus 1 (HIV-1)
Product: TOPIRAMATE

Primary endpoint: 1. The fold change in cell-associated (CA) HIV-1 RNA after topiramate treatment (T2 (6h), T3 (24h)) compared to baseline (T0). 2. The frequency and severity of adverse events after topiramate treatment.
Endpoint(s): 1. The change in CA HIV-1 RNA compared between arms. 2. Plasma concentrations of topiramate compared between arms. 3. The frequency and severity of adverse events compared between arms. 4. The change in reservoir size after topiramate treatment compared to baseline. 5. The plasma concentration of topiramate compared to CA HIV-1 RNA.

Source: https://euclinicaltrials.eu/ctis-public/view/2024-511532-27-00